EU clinical trial 2022-500573-13-00: A Dose Finding Phase 1 Study of CC-96191 in Subjects with Relapsed or Refractory Acute Myeloid Leukemia
Protocol code: CC-96191-AML-001
Sponsor: Celgene Corp. (Pharmaceutical company). Phase: Human Pharmacology (Phase I)- First administration to humans. Countries: France (ended).
Therapeutic area(s): Diseases [C] - Neoplasms [C04]
Gender: Female, Male. Age: 18-64 years, 65+ years. Enrolment: 22.
Status: Ended. Start date (EU): 2021-07-06. End date (EU): 2025-02-24. End date: 2025-04-14. Decision date: 2022-11-14. Results received: No. Last updated: 2025-02-07.

Condition(s): Relapsed or Refractory Acute Myeloid Leukemia

Source: https://euclinicaltrials.eu/ctis-public/view/2022-500573-13-00